EU clinical trial 2024-513475-41-00: DISEASE MODIFYING THERAPIES WITHDRAWAL IN INACTIVE RELAPSING-REMITTING MULTIPLE SCLEROSIS PATIENTS AGED 55 AND OVER: A MULTICENTRIC, RANDOMIZED, CONTROLLED, OPEN-LABEL CLINICAL TRIAL - TWINS
Sponsor: Les Hopitaux Universitaires De Strasbourg (Hospital/Clinic/Other health care facility). Phase: Therapeutic confirmatory (Phase III). Countries: France (ongoing, recruiting).
Therapeutic area(s): Diseases [C] - Nervous System Diseases [C10]
Gender: Female, Male. Age: 18-64 years, 65+ years. Enrolment: 200.
Status: Ongoing, recruiting. Start date (EU): 2025-02-03. Decision date: 2024-08-27. Results received: No. Last updated: 2026-06-26.

Condition(s): Multiple Sclerosis
Product: Betaferon 250 microgram/ml, powder and solvent for solution for injection, Vumerity 231 mg gastro-resistant hard capsules, Tecfidera 240 mg gastro-resistant hard capsules, Plegridy 63 micrograms + 94 micrograms solution for injection in pre-filled syringe, Rebif 44 micrograms solution for injection in pre-filled syringe, AUBAGIO 14 mg film-coated tablets, Copaxone 20 mg/ml, solution injectable en seringue préremplie, AVONEX 30 micrograms/0.5ml solution for injection in pre-filled pen.

Primary endpoint: Time to first clinical and/or radiological disease activity during a period of 2 years.
Endpoint(s): Secondary endpoints will be measured by comparing baseline scores/evaluations (M0) with the scores/evaluations at M6, M12, M18, and M24: 1. Kaplan Meier analysis of time to relapse, 2. Annual relapse rate (ARR), 3. Transition to secondary progressive multiple sclerosis according to revised McDonald 2017 criteria, 4. Scores at EDSS, 25Foot/Walk, 9-HPT tests, 5. Scores at CSCT questionnaire, 6. Scores at SEP-59, EQ-5D, Hospital Anxiety and Depression (HAD) and Burden of Treatment (TBQ) Questionnaires, 7. Safety of treatments will be followed by the number and type of adverse or severe adverse events (AE/SAE) throughout the protocol ; Clinical examination, patient questioning; biological analysis in the case of suspected infection, 8. MS comorbidities questionnaire, 9. Average annual cost, incremental ratio cost/effectiveness and cost/utility ratios

Source: https://euclinicaltrials.eu/ctis-public/view/2024-513475-41-00